EU clinical trial 2024-513143-82-00: A Phase 1b, Double-blind, Placebo-controlled, Randomised Trial Investigating the Effect of AZD3427 on Renal Perfusion in HFrEF Patients With Renal Impairment Using Positron Emission Tomography (PET)
Protocol code: D8330C00004
Sponsor: AstraZeneca AB (Pharmaceutical company). Phase: Human Pharmacology (Phase I)- Other. Countries: Sweden (ended).
Therapeutic area(s): Diseases [C] - Cardiovascular Diseases [C14]
Gender: Female, Male. Age: 18-64 years, 65+ years. Enrolment: 12.
Status: Ended. Start date (EU): 2024-10-15. End date (EU): 2025-08-21. Decision date: 2024-08-28. Results received: Yes. Last updated: 2025-02-11.

Condition(s): Heart failure with reduced ejection fraction, Renal impairment
Product: 15O-WATER, Natriumklorid Fresenius Kabi, 9 mg/ml, infusionsvätska, lösning, AZD3427, Dopamin Fresenius 50 mg/5 ml, Konzentrat zur Herstellung einer Infusionslösung, Placebo for AZD3427 or AZD3427 diluent

Primary endpoint: The volumetric fraction (%) of the renal cortex with increased perfusion from baseline to Day 8, compared to placebo, as measured by quantitative parametric mapping using PET.
Endpoint(s): Safety and tolerability will be evaluated in terms of AEs, vital signs, clinical laboratory assessments, and ECG.

Source: https://euclinicaltrials.eu/ctis-public/view/2024-513143-82-00